EU clinical trial 2024-510787-23-00: Maternal pertussis immunization in Finland, 4 years (MIFI-4Y)
Protocol code: MIFI-4Y
Sponsor: Varsinais-Suomen hyvinvointialue (Hospital/Clinic/Other health care facility). Phase: Therapeutic use (Phase IV). Countries: Finland (ended).
Therapeutic area(s): Diseases [C] - Bacterial Infections and Mycoses [C01]; Diseases [C] - Respiratory Tract Diseases [C08]
Gender: Female, Male. Age: 0-17 years, 18-64 years. Enrolment: 138.
Status: Ended. Start date (EU): 2024-05-07. End date (EU): 2025-07-07. Decision date: 2024-04-30. Results received: No. Last updated: 2024-05-06.
Decision dates by country: FI: 2024-05-06

Condition(s): Pertussis
Product: Tetravac, injektioneste, suspensio Adsorboitu kurkkumätä-, jäykkäkouristus-, hinkuyskä- (soluton, komponentti) ja polio (inaktivoitu) - rokote

Primary endpoint: PT-specific IgG antibody geometric mean concentration (GMC) at 4 years+28 days in children from Arm 1 versus Arm 2.

Source: https://euclinicaltrials.eu/ctis-public/view/2024-510787-23-00